EU clinical trial 2026-526289-25-00: VATS or Intrapleural Enzymatic Therapy for patientS with empyema (the VIETS trial)
Sponsor: Amsterdam UMC Stichting (Patient organisation/association). Phase: Therapeutic use (Phase IV). Countries: Netherlands (authorised, recruitment pending).
Therapeutic area(s): Diseases [C] - Respiratory Tract Diseases [C08]; Diseases [C] - Bacterial Infections and Mycoses [C01]; Analytical, Diagnostic and Therapeutic Techniques and Equipment [E] - Diagnosis [E01]; Analytical, Diagnostic and Therapeutic Techniques and Equipment [E] - Therapeutics [E02]
Gender: Female, Male. Age: 18-64 years, 65+ years. Enrolment: 164.
Status: Authorised, recruitment pending. Decision date: 2026-07-24. Results received: No. Last updated: 2026-07-24.

Condition(s): Parapneumonic pleural infection/pleural empyema
Product: Actilyse 20 mg, poeder en oplosmiddel voor oplossing voor injectie en infusie, Pulmozyme 2500 E/2,5 ml, verneveloplossing

Primary endpoint: Length of hospital stay (LOS) during the first 30 days.
Endpoint(s): Measures related to treatment (duration of chest tube drainage, delayed discharge days, re-intervention and re-admission rates, morbidity, mortality, type and duration of antibiotic treatment and pain medication)., Patient reported outcomes (pain, health related quality of life, limitations in daily activities, return to work)., Economic evaluation (healthcare costs, costs of patient, costs of productivity loss, health related quality of life).

Source: https://euclinicaltrials.eu/ctis-public/view/2026-526289-25-00